EU clinical trial 2023-505096-68-00: A Multicenter, Randomized, Placebo-Controlled, Double-Blind, Parallel-Group Study, to Assess Efficacy, Safety and Immunogenicity of JNJ-64042056, a Phosphorylated Tau Targeted Active Immunotherapy, in Participants with Preclinical Alzheimer’s Disease
Protocol code: 64042056ALZ2001
Sponsor: Janssen - Cilag International (Pharmaceutical company). Phase: Therapeutic exploratory (Phase II). Countries: Belgium (ended), Spain (temporarily halted), Germany (ended), Sweden (ended), France (temporarily halted).
Therapeutic area(s): Diseases [C] - Nervous System Diseases [C10]
Gender: Female, Male. Age: 18-64 years, 65+ years. Enrolment: 83.
Start date (EU): 2025-01-14. Decision date: 2024-10-08. Results received: No. Last updated: 2026-07-07.
Decision dates by country: SE: 2024-10-14, BE: 2024-10-10, DE: 2024-10-09, FR: 2024-12-11, ES: 2024-10-08

Condition(s): Preclinical Alzheimer’s Disease
Product: florquinitau F18, JNJ-64042056, JNJ-64042056

Primary endpoint: Change from baseline in brain tau burden, as measured by tau PET in specified ROIs (including but not limited to Braak I-VI ROIs, Tau Naïve Composite ROI, Connection Rank ROI, and New Tau Composite ROI Volume)

Source: https://euclinicaltrials.eu/ctis-public/view/2023-505096-68-00